EU clinical trial 2025-522966-61-00: A clinical study to investigate the safety, tolerability and pharmacokinetic profile of single ascending concentrations of OPT101 in peritoneal dialysis patients.
Protocol code: OPT-001
Sponsor: OPTERION Health AG (Pharmaceutical company). Phase: Human Pharmacology (Phase I)- First administration to humans. Countries: Latvia (ended).
Therapeutic area(s): Not possible to specify
Gender: Female, Male. Age: 18-64 years, 65+ years. Enrolment: 12.
Status: Ended. Start date (EU): 2026-02-16. End date (EU): 2026-05-28. Decision date: 2026-01-09. Results received: No. Last updated: 2026-01-09.

Condition(s): Chronic kidney disease

Source: https://euclinicaltrials.eu/ctis-public/view/2025-522966-61-00